EU clinical trial 2023-508643-46-00: Comparison of the efficacy and safety of valaciclovir in the prevention of transmission and treatment of intrauterine infection in pregnant women with primary cytomegalovirus infection depending on the used drug dose - the first Polish non-commercial non-inferiority clinical trial.
Protocol code: POL PRENATAL CMV
Sponsor: Instytut Matki I Dziecka (Hospital/Clinic/Other health care facility). Phase: Therapeutic exploratory (Phase II). Countries: Poland (ongoing, recruiting).
Therapeutic area(s): Diseases [C] - Female Urogenital Diseases and Pregnancy Complications [C13]
Gender: Female. Age: 18-64 years. Enrolment: 200.
Status: Ongoing, recruiting. Start date (EU): 2024-08-02. Decision date: 2024-02-26. Results received: No. Last updated: 2026-03-10.

Condition(s): primary cytomegalovirus (CMV) infection
Product: VALACICLOVIR

Primary endpoint: Percentage of newborns in whom CMV DNA was not detected in the amniotic fluid in the compared groups (assessed at visits 4 and 5).
Endpoint(s): CMV DNA replication level in fetal blood according to CMV DNA replication level in maternal blood (assessed at visit 5)., Platelet count in the fetus depending on the dose of drug used (assessed at visit 5), Percentage of missed doses of a drug in the compared groups (assessed by interview at each visit, from 1 to 5)., The percentage of newborns in whom the presence of CMV DNA in the amniotic fluid was not detected in the compared groups depending on the level of virus replication in the amniotic fluid (assessed on visits 4 and 5)., Assessment of the frequency of adverse events in the study groups.

Source: https://euclinicaltrials.eu/ctis-public/view/2023-508643-46-00